EU clinical trial 2024-515247-28-00: Expanded access program for mepolizumab in subjects with hypereosinophilic syndrome.
Protocol code: 104317
Sponsor: Glaxosmithkline Research & Development Limited (Pharmaceutical company). Phase: Therapeutic confirmatory (Phase III). Countries: Poland (ended).
Therapeutic area(s): Not possible to specify; Diseases [C] - Hemic and Lymphatic Diseases [C15]
Gender: Female, Male. Age: 0-17 years, 18-64 years. Enrolment: 9.
Status: Ended. Start date (EU): 2019-03-29. End date (EU): 2025-10-03. End date: 2026-03-16. Decision date: 2024-07-30. Results received: No. Last updated: 2025-03-02.

Condition(s): Hypereosinophilic Syndrome

Primary endpoint: "SAEs Non-serious AEs related to mepolizumab as assessed by the Investigator Mean 28-day SC dose (mg) for the last 3 administrations"

Source: https://euclinicaltrials.eu/ctis-public/view/2024-515247-28-00